EU clinical trial 2023-505318-97-00: A Randomized Intervention, Multi-Center Study to Determine the Role of Dexamethasone eye drops against proliferative retinopathy of prematurity
Protocol code: DROPROP
Sponsor: Vaestra Goetalandsregionen (Hospital/Clinic/Other health care facility). Phase: Therapeutic confirmatory (Phase III). Countries: Sweden (ongoing, recruitment ended).
Therapeutic area(s): Diseases [C] - Eye Diseases [C11]
Gender: Female, Male. Age: 0-17 years. Enrolment: 100.
Status: Ongoing, recruitment ended. Start date (EU): 2022-09-22. Decision date: 2023-08-30. Results received: No. Last updated: 2025-12-11.

Condition(s): Retinopathy of Prematurity
Product: DEXAFREE 1 mg/ml, collyre en solution en récipient unidose, "DROP-it" ögondroppar 5 ml Physiologic saline 0,9 % natriumklorid i 100 ml renat vatten

Primary endpoint: The proportion of infants with ROP progression to Type 1 ROP needing conventional treatment in each study arm.
Endpoint(s): 1. Time from detection of proliferative ROP to Type 1 ROP, 2. Recurrences after laser/Anti-VEGF treatment in dexamethasone treatment and placebo arm, 3. Retinal morphology at 40 weeks PMA and at 2.5 and 6.5 years with optical coherence tomography (OCT), 4. Measurements of intraocular pressure before treatment at 1 and 2 weeks after start of treatment and after completed treatment and at 2.5 and 6.5 years of age, 5. Visual outcome and refractive errors at 2.5 and 6.5 years of age, 6. To analyse leftovers of blood from the clinical blood sampling with regard to selected biomarkers and their relation to ROP development and treatment effect

Source: https://euclinicaltrials.eu/ctis-public/view/2023-505318-97-00